EU clinical trial 2024-517176-38-00: lmlifidase treatment tor acute inflammation in AQP4-lgG associated neuromyelitis optica spectrum disorder (DEFEAT NMOSD)
Protocol code: NL80681.078.22
Sponsor: Erasmus Universitair Medisch Centrum Rotterdam (Erasmus MC) (Hospital/Clinic/Other health care facility). Phase: Therapeutic exploratory (Phase II). Countries: Netherlands (ongoing, recruitment ended).
Therapeutic area(s): Diseases [C] - Nervous System Diseases [C10]
Gender: Female, Male. Age: 18-64 years, 65+ years. Enrolment: 5.
Status: Ongoing, recruitment ended. Start date (EU): 2025-08-31. Decision date: 2024-09-10. Results received: No. Last updated: 2026-06-15.

Condition(s): neuromyelitis optica spectrum disorder, devic disease
Product: Idefirix 11 mg powder for concentrate for solution for infusion

Primary endpoint: The proportion of participants with a depletion of circulating pathogenie anti-AQP4 lgG antibodies, below detection limits as measured with a state-of-the-arts cell-based assay in the timeframe within 6h after treatment.

Source: https://euclinicaltrials.eu/ctis-public/view/2024-517176-38-00